EU clinical trial 2024-516965-35-00: TAWIS - Evaluation of TNF-alpha antagonists (Infliximab) withdrawal in sarcoidosis : a prospective, randomized, controlled trial.
Sponsor: Assistance Publique Hopitaux De Paris (Hospital/Clinic/Other health care facility). Phase: Therapeutic confirmatory (Phase III). Countries: France (ongoing, recruitment ended).
Therapeutic area(s): Diseases [C] - Immune System Diseases [C20]
Gender: Female, Male. Age: 18-64 years, 65+ years. Enrolment: 90.
Status: Ongoing, recruitment ended. Start date (EU): 2024-10-28. Decision date: 2024-10-28. Results received: No. Last updated: 2025-03-21.

Condition(s): Immune system disorders
Product: METHOTREXATE, INFLIXIMAB, AZATHIOPRINE

Primary endpoint: The primary endpoint is the percentage of patients with major relapses in the 2 groups

Source: https://euclinicaltrials.eu/ctis-public/view/2024-516965-35-00